EU clinical trial 2025-522368-34-00: A study investigating the safety, tolerability, pharmacokinetics (absorption, distribution, metabolism and elimination) and effect of single and multiple doses of MTX46943, a new compound that may potentially be used in the treatment of Alzheimer’s disease and other neurological disorders
Protocol code: MNA-001-01
Sponsor: Muna Therapeutics ApS (Pharmaceutical company). Phase: Human Pharmacology (Phase I)- First administration to humans. Countries: Netherlands (ended).
Therapeutic area(s): Diseases [C] - Nervous System Diseases [C10]
Gender: Female, Male. Age: 18-64 years, 65+ years. Enrolment: 123.
Status: Ended. Start date (EU): 2025-09-05. End date (EU): 2026-07-09. Decision date: 2025-09-04. Results received: No. Last updated: 2026-02-26.

Condition(s): Alzheimer’s Disease

Source: https://euclinicaltrials.eu/ctis-public/view/2025-522368-34-00